EU clinical trial 2023-509838-19-00: Repurposing Everolimus to enhance musculoskeletal Vitality and Ageing in The Elderly (RENOVATE)
Sponsor: Odense University Hospital (Hospital/Clinic/Other health care facility). Phase: Therapeutic exploratory (Phase II). Countries: Denmark (authorised, recruitment pending).
Therapeutic area(s): Diseases [C] - Musculoskeletal Diseases [C05]
Gender: Female, Male. Age: 65+ years. Enrolment: 120.
Status: Authorised, recruitment pending. Decision date: 2024-03-14. Results received: No. Last updated: 2026-03-24.

Condition(s): General healthy elderly with stable medical conditions
Product: Afinitor 5 mg tablets, PLACEBO, Tetracycline Capsules 250 mg

Primary endpoint: Changes in serum bone formation marker P1NP
Endpoint(s): Changes in serum bone resorption marker CTX, Changes in areal BMD at the lumbar spine, total hip and femoral neck measured by DXA scanning, Changes in volumetric BMD, bone microstructures and estimated strength at distal tibia and radius (HRpQT), Changes in muscle function, power and strength for upper and lower extremities will be assessed using a standard hydraulic hand dynamometer, the 30-second sit-to-stand test (RSS), respectively and gait speed., Changes in health-related quality of life assessment (SF-12 questionnaire)

Source: https://euclinicaltrials.eu/ctis-public/view/2023-509838-19-00